EU clinical trial 2024-514467-26-00: A Phase 2 Multicenter Study of TL-895 in Subjects with Myelofibrosis, Indolent Systemic Mastocytosis, Monoclonal Mast Cell Activation Syndrome, or Non-Monoclonal Mast Cell Activation Syndrome
Protocol code: TL-895-201
Sponsor: Telios Pharma Inc. (Pharmaceutical company). Phase: Therapeutic exploratory (Phase II). Countries: Germany (ongoing, recruiting), Italy (ongoing, recruiting), Spain (ongoing, recruiting), Belgium (ongoing, recruiting), Bulgaria (ended), France (ended), Poland (ongoing, recruitment ended), Netherlands (authorised, recruiting), Norway (ongoing, recruiting).
Therapeutic area(s): Diseases [C] - Hemic and Lymphatic Diseases [C15]
Gender: Female, Male. Age: 18-64 years, 65+ years. Enrolment: 188.
Start date (EU): 2021-04-07. Decision date: 2024-07-11. Results received: No. Last updated: 2026-07-21.
Decision dates by country: FR: 2024-07-16, BG: 2024-07-15, BE: 2024-07-18, NO: 2026-04-28, PL: 2024-08-04, NL: 2026-04-28, DE: 2024-07-15, ES: 2024-07-11, IT: 2024-07-29

Condition(s): Indolent Systemic Mastocytosis
Product: TL-895, TL-895 matching placebo, TL-895, TL-895, TL-895, TL-895

Primary endpoint: Cohorts 1-4: Part A: Determine the RP2D of TL-895, Cohorts 1-4: Part B: The proportion of subjects achieving ≥ 50% reduction in TSS at Week 24 by MFSAF v4.0, Cohort 5: Part A: The recommended TL-895 dosing regimen(s) will be determined based on safety, efficacy, and tolerability data, Cohort 5: Part B Mean change in ISM-TSAF TSS from Baseline to Week 24, Cohort 6: Part A: The recommended phase 3 dose will be determined based on safety, efficacy, and tolerability data
Endpoint(s): Cohorts 1-4: Part A: The proportion of subjects achieving ≥ 35% SVR at Week 24 by magnetic resonance imaging (MRI) or computed tomography (CT) scan (central review), Cohorts 1-4: Part B: The proportion of subjects achieving a platelet response defined as per International Working Group – Myeloproliferative Neoplasms Research and Treatment (IWG-MRT 2006) criteria specified in the study protocol, Cohort 5: Part B: Changes in patient reported symptoms

Source: https://euclinicaltrials.eu/ctis-public/view/2024-514467-26-00